EU clinical trial 2024-517753-27-01: A multicenter, randomized clinical trial comparing the efficacy and safety of certolizumab pegol and belimumab in patients with moderate or severe activity of systemic lupus erythematosus (CERT-SLE)
Protocol code: NIGRiR_006CERT-SLE
Sponsor: Narodowy Instytut Geriatrii Reumatologii I Rehabilitacji Im Prof. Dr Hab. Med. Eleonory Reicher (Hospital/Clinic/Other health care facility). Phase: Therapeutic confirmatory (Phase III). Countries: Poland (authorised, recruitment pending).
Therapeutic area(s): Diseases [C] - Immune System Diseases [C20]
Gender: Female, Male. Age: 18-64 years, 65+ years. Enrolment: 90.
Status: Authorised, recruitment pending. Decision date: 2025-10-31. Results received: No. Last updated: 2025-10-31.

Condition(s): moderate or severe activity of systemic lupus erythematosus (SLE)
Product: CERTOLIZUMAB PEGOL, BELIMUMAB, BELIMUMAB

Primary endpoint: Proportion of patients who achieved an SRI-4 response defined as a decrease of ≥ 4 points on the SELENA-SLEDAI scale, no new BILAG A organ score and no more than 1 new BILAG B score, and no worsening (increase < 0.3) in the Physician Global Assessment (PGA) score from baseline at Week 52
Endpoint(s): Percentage of patients achieving SRI-4 response at week 52 with concomitant glucocorticosteroid dose reduction to <10 mg/d, Percentage of patients achieving SRI-4 response at week 26 with concomitant glucocorticosteroid dose reduction to <10 mg/d, Change from baseline in Physician Global Assessment of Disease Activity (PGA) at week 52, Change from Baseline in the 36-Item Short Form Health Survey (SF-36) Quality of Life Scale at Week 52, Percentage of patients achieving LLDAS (Lupus Low Disease Activity State) at week 52, defined as: ● SLEDAI-2k ≤4 and no disease activity in major organs (kidneys, central nervous system [CNS], heart, lungs), no vasculitis, fever, hemolytic anemia, gastrointestinal activity ● no new disease activity symptoms compared to previous assessment ● physician's global assessment of activity phPGA ≤1 on a 0-3 scale ● current dose of glucocorticosteroids in prednisone equivalent ≤7.5 mg/day ● well-tolerate, Change from baseline in fatigue at weeks 26 and 52 as measured by the FACIT fatigue score, Change from baseline in tender joint count (from 28 joints) at week 52, Change from baseline in number of swollen joints (of 28 joints) at week 52, Reduction of skin lesions assessed according to the CLASI scale at week 52

Source: https://euclinicaltrials.eu/ctis-public/view/2024-517753-27-01